EU clinical trial 2024-517789-41-00: CLINICAL AND HUMORAL IMPACT OF PRIMARY TUMOR ABLATION IN METASTATIC RENAL CELL CARCINOMA TREATED WITH IMMUNOTHERAPY.THE ITALIC-RCC RANDOMIZED STUDY
Protocol code: ITALIC-RCC
Sponsor: Fondazione Policlinico Universitario Agostino Gemelli IRCCS (Hospital/Clinic/Other health care facility). Phase: Therapeutic use (Phase IV). Countries: Italy (ongoing, recruiting).
Therapeutic area(s): Diseases [C] - Neoplasms [C04]
Gender: Female, Male. Age: 18-64 years, 65+ years. Enrolment: 409.
Status: Ongoing, recruiting. Start date (EU): 2025-07-04. Decision date: 2025-03-18. Results received: No. Last updated: 2025-11-17.

Condition(s): metastatic or locally advanced renal cell carcinoma
Product: LENVATINIB, NIVOLUMAB, CABOZANTINIB, LENVATINIB, NIVOLUMAB, AXITINIB, CABOZANTINIB, PEMBROLIZUMAB, IPILIMUMAB, AXITINIB, AXITINIB

Primary endpoint: The primary endpoint of the study is to assess the difference in overall survival (OS) between patients who receive or not the deferred citoreductive nephrectomy (CN) while on therapy with SOC for mRCC
Endpoint(s): To assess the difference in overall survival (OS) between patients who receive or not the deferred citoreductive nephrectomy (CN) while on therapy with SOC for mRCC from the beginning of the anti-PD1-based therapy, To assess the difference in progression-free survival (PFS) between patients who receive or not the deferred citoreductive nephrectomy (CN) while on therapy with SOC for mRCC, To assess the difference in overall survival (OS) between patients who receive or not the radiotherapy on primary tumor while on therapy with SOC for mRCC among those with primary tumor up to 4 cm at randomization, To assess the difference in progression-free survival (PFS) between patients who receive or not the radiotherapy on primary tumor while on therapy with SOC for mRCC among those with primary tumor up to 4 cm at randomization., To evaluate the safety of the CN and RT on primary tumor among patients receiving SOC for mRCC. Adverse events will be graded according to NCI CTCAE version 5.0, To evaluate the quality of life before and after 8 weeks from the CN or RT on primary tumor among patients receiving SOCfor mRCC evaluated by the questionnaires EQ-5D-5L and FKSI-19 and the surgical complications by the Clavien-Dindo classification, Translational endpoint: To describe as different strategies (CN or RT) affect the patient’s proteome and the correlation between the proteome profile at baseline or its changes with the outcome (i.e.: PFS and OS) to SOC, Translational endpoint: • To describe as the expression of some markers such as PD-L1, PBRM1, BAP1, and presence of CD4 and C8 lymphocytes correlated with the outcome (i.e.: PFS and OS) in the different groups of patients

Source: https://euclinicaltrials.eu/ctis-public/view/2024-517789-41-00